EU clinical trial 2024-513663-10-01: A Phase 1 study of GSK5764227 in participants with advanced solid tumors
Protocol code: 223054
Sponsor: Glaxosmithkline Research & Development Limited (Pharmaceutical company). Phase: Human Pharmacology (Phase I)- Other. Countries: Italy (ongoing, recruiting), France (ongoing, recruiting), Spain (ongoing, recruiting).
Therapeutic area(s): Diseases [C] - Neoplasms [C04]
Gender: Female, Male. Age: 18-64 years, 65+ years. Enrolment: 276.
Status: Ongoing, recruiting. Start date (EU): 2025-09-17. Decision date: 2025-08-11. Results received: No. Last updated: 2026-07-29.
Decision dates by country: ES: 2025-08-14, FR: 2025-08-12, IT: 2025-08-11

Condition(s): Neoplasms

Source: https://euclinicaltrials.eu/ctis-public/view/2024-513663-10-01